EU clinical trial 2022-502505-15-00: A Phase 2 Safety, Tolerability, and Proof-of-Concept Study of VGL101 in Patients With Adult-Onset Leukoencephalopathy With Axonal Spheroids and Pigmented Glia (ALSP)
Protocol code: VGL101-01.201
Sponsor: Vigil Neuroscience Inc. (Pharmaceutical company). Phase: Phase II and Phase III (Integrated). Countries: Germany (ended), Netherlands (ended), France (ended).
Therapeutic area(s): Diseases [C] - Nervous System Diseases [C10]; Diseases [C] - Congenital, Hereditary, and Neonatal Diseases and Abnormalities [C16]
Gender: Female, Male. Age: 18-64 years, 65+ years. Enrolment: 7.
Status: Ended. Start date (EU): 2023-11-09. End date (EU): 2025-06-04. Decision date: 2023-07-24. Results received: Yes. Last updated: 2025-01-28.
Decision dates by country: FR: 2024-01-18, NL: 2023-10-25, DE: 2023-07-26

Condition(s): Leukoencephalopathy
Product: VGL101

Primary endpoint: Safety and tolerability, as assessed by the following: Nature and frequency of adverse events, serious adverse events, and discontinuations due to adverse events; Safety laboratory tests; Immunogenicity tests; Vital sign measurements; Electrocardiograms; Columbia-Suicide Severity Rating Scale (C-SSRS)
Endpoint(s): Secondary end pointT Change from Baseline to Week 24 and Week 52 in structural and volumetric magnetic resonance imaging (MRI)Change from Baseline to Week 24 in neurofilament light chain (NfL) in cerebrospinal fluid (CSF) and blood, Change from Baseline to Week 24 and Week 52 in neurofilament light chain (NfL) in cerebrospinal fluid (CSF) and blood, Change from Baseline to Week 24 and Week 52 in in soluble colony-stimulating factor 1 receptor (sCSF1R) in CSF, Correlations of Week 24 and Week 52 biomarker changes and clinical outcomes

Source: https://euclinicaltrials.eu/ctis-public/view/2022-502505-15-00